EU clinical trial 2023-508173-90-00: Intravenous lidocaine and post operative recovery after liver surgery – a randomized double blinded study
Sponsor: Region Skane (Hospital/Clinic/Other health care facility). Phase: Phase II and Phase III (Integrated). Countries: Sweden (ended).
Therapeutic area(s): Analytical, Diagnostic and Therapeutic Techniques and Equipment [E] - Anesthesia and Analgesia [E03]
Gender: Female, Male. Age: 18-64 years, 65+ years. Enrolment: 124.
Status: Ended. Start date (EU): 2021-11-15. End date (EU): 2025-12-06. Decision date: 2024-09-30. Results received: No. Last updated: 2024-09-30.

Condition(s): Patients with liver tumours that have liver surgery performed
Product: LIDOCAINE, SODIUM CHLORIDE

Primary endpoint: Total opioid consumption the first 24 hours. (mg morfin equivalents)
Endpoint(s): Total opioid consumption the first 48 hours. (mg morfin equivalents), Postoperative intensity of pain, NRS (numerical rating scale), Complications (Clavien-Dindo), Total Intravenous Opioid consumption in the first 24 hours, and after the first 48 hours (mg morfin equivalents), Total opioid consumption by day 3, 4, 5 (mg morfin equivalenter), Time to flatus, Time to bowel movement, Nausea, vomiting, Length of stay in hospital, Mortality, Lidocaine- and MEGX-koncentration in blood immediately after induction of anestesia , 30 minutes after resection and at the end of infusion., QoR-40, adverse events

Source: https://euclinicaltrials.eu/ctis-public/view/2023-508173-90-00